EU clinical trial 2024-518989-27-01: Treating Leg Symptoms in Women with X-linked Adrenoleukodystrophy: A Key to Improving Sleep and Gait Performance
Protocol code: RLS
Sponsor: Amsterdam UMC Stichting (Patient organisation/association). Phase: Therapeutic use (Phase IV). Countries: Netherlands (ended).
Therapeutic area(s): Diseases [C] - Nervous System Diseases [C10]
Gender: Female. Age: 18-64 years, 65+ years. Enrolment: 50.
Status: Ended. Start date (EU): 2024-02-04. End date (EU): 2025-12-01. Decision date: 2024-12-17. Results received: No. Last updated: 2024-12-17.

Condition(s): X-linked adrenoleukodystrophy, Restless legs
Product: Pramipexole Viatris 0,088 mg tabletten

Primary endpoint: 1. Subjective total sleep time, 2. Subjective sleep latency, 3. Subjective time awake after sleep onset, 4. Depressive (PHQ-9) and anxiety (GAD-7) symptoms, 5. Quality of life measures (SF-36), 6. Functional measures: EDSS, 25-FW, and TUG

Source: https://euclinicaltrials.eu/ctis-public/view/2024-518989-27-01